EU clinical trial 2023-503963-41-00: Implementation of Out-of-HOspital administration of the Long-Acting combination cabotegravir+rilpivirine as an optional therapy in HIV-Infected patients from Spain. Acceptability, appropriateness, feasibility and satisfaction. The HOLA Study.
Protocol code: Out-of-hospital
Sponsor: Fundacion Fls De Lucha Contra El Sida Las Enfermedades Infecciosas Y La Promocion De La Salud Y La C (Patient organisation/association). Phase: Therapeutic use (Phase IV). Countries: Spain (ended).
Therapeutic area(s): Diseases [C] - Virus Diseases [C02]
Gender: Female, Male. Age: 18-64 years. Enrolment: 110.
Status: Ended. Start date (EU): 2023-10-05. End date (EU): 2025-05-30. Decision date: 2023-08-01. Results received: No. Last updated: 2024-06-07.

Condition(s): HIV-Infected patients
Product: EDURANT 25 mg film-coated tablets, REKAMBYS 900 mg prolonged-release suspension for injection, Vocabria 600 mg prolonged-release suspension for injection, Vocabria 30 mg film-coated tablets

Primary endpoint: To assess and compare acceptability, we will use the Acceptability Intervention Measure (AIM) questionnaire - Number and proportion of participants receiving injections that show an average composite score ≥ 4 across the AIM questionnaires at month 12.- Differences among the proportion of participants receiving injections with an average composite score ≥ 4 across the AIM questionnaires at month 12- Average composite score across the AIM questionnaires at 12., To assess and compare the safety and tolerability of LA CAB+RPV: Incidence and severity of CAB + RPV LA–related AEs, all SAEs, ISRs or post injection reactions. % of participants who discontinue CAB + RPV LA due to AEs/SAEs at any time, and at m6&m12. Comparing between groups number and % of patients who withdraw treatment study at m6&m12 due to antiretroviral-related AE and reasons.Comparing between groups number and % patients whith grade 3 or 4 antiretroviral-related AEs at m6&m12.
Endpoint(s): - Number and proportion of participants receiving injections with an average composite score ≥ 4 across the AIM questionnaires at month 1 and 6, as perceived by the patient. - Differences among the proportion of participants receiving injections with an average composite score ≥ 4 across the AIM questionnaires at month 1 and 6. - Average composite score across the AIM questionnaires at month 1 and 6, - Number and proportion of participants receiving injections with an average composite score ≥ 4 across the IAM / FIM questionnaires at months 1, 6 and 12, as perceived by the patient. - Differences among the proportion of participants receiving injections with an average composite score ≥ 4 across the IAM /FIM questionnaires at month 1, 6 and 12. - Average composite score across the IAM /FIM questionnaires at month 1, 6 and 12., - Number and proportion of HCP and/or nonclinical staff that show an average composite score ≥ 4 across the AIM / IAM /FIM questionnaires at months 1, 6 and 12. - Differences among the proportion of HCP/non-clinical staff with an average composite score ≥ 4 across the AIM / IAM /FIM questionnaires at month 1, 6 and 12. - Average composite score across the AIM / IAM /FIM questionnaires at month 1, 6 and 12., -Compare % patients high satisfaction baseline & 1, 6&12m (HIVTSQs12). -Assess satisfaction changes (HIVTSQs12) baseline to 1,6&12m .-Assess satisfaction changes (HIVTSQc12) baseline to 12m- Assess and compare groups expectations of LA CAB+RPV regarding areas.-Compare groups PROMs baseline& 1,6&12 m (PROMS- CST-HIV questionnaire). -Assess changes (PROMs) in groups baseline to 1,6 &12m.- Compare changes health professionals ‘expectations baseline to end-Compare perception of injection (PIN)., - Compare among groups number and proportion of patients who miss appointment LA CAB+RPV administration from baseline to month 6&12 - Compare among groups number and proportion of patients who early interrupt LA CAB+RPV every 2 months,at month 6&12. - Compare among groups number and proportion of patients who withdraw treatment study at month 6&12. - Time to LA CAB + RPV discontinuation. - Compare among groups the number and proportion of patients who adopt oral bridging therapy during 12months., - To identify those patients in which the out-of-hospital administration is more suitable by comparing the previous endpoints, stratifying according to: age (< vs >50 years old), gender (male vs female), as well as according to if the participant is already receiving or not LA CAB+RPV (Clinical study).

Source: https://euclinicaltrials.eu/ctis-public/view/2023-503963-41-00